EU clinical trial 2025-522949-22-00: A Phase 3, Multicenter, Randomized, Double-Blind, Placebo-Controlled Study to Investigate the Efficacy of a Single Intravenous Dose of SGT-003 in Ambulant Males With Duchenne Muscular Dystrophy
Protocol code: SGT-003-301
Sponsor: Solid Biosciences Inc. (Pharmaceutical company). Phase: Therapeutic confirmatory (Phase III). Countries: Spain (authorised, recruitment pending), Netherlands (authorised, recruitment pending), France (authorised, recruitment pending), Italy (authorised, recruitment pending), Belgium (authorised, recruitment pending), Germany (not authorised).
Therapeutic area(s): Diseases [C] - Musculoskeletal Diseases [C05]
Gender: Male. Age: 0-17 years. Enrolment: 62.
Decision date: 2026-05-26. Results received: No. Last updated: 2026-06-01.
Decision dates by country: FR: 2026-05-29, DE: 2026-06-01, IT: 2026-05-29, ES: 2026-05-26, NL: 2026-05-27, BE: 2026-05-28

Condition(s): Duchenne muscular dystrophy
Product: Normal saline (0.9% sodium chloride) for infusion

Primary endpoint: Change from baseline in time to rise velocity at Day 540
Endpoint(s): Change from baseline in stride velocity 95th centile (SV95C) by activity monitoring using the Syde wearable device at Day 540, Change from baseline in 10-meter walk/run velocity at Day 540, Change from baseline in 4-stair climb velocity at Day 540, Change from baseline in absolute NSAA score at Day 540, Cumulative loss of function in North Star Ambulatory Assessment (NSAA) items at Day 540, Change from baseline in microdystrophin protein levels at Day 90, Change from baseline in microdystrophin tissue distribution at Day 90, Change from baseline in % predicted forced vital capacity (FVC) at Day 540, Change from baseline in % predicted peak expiratory flow (PEF) at Day 540, Change from baseline in % predicted forced expiratory volume in 1 second (FEV1) at Day 540, Incidence of treatment-emergent adverse events through Day 540, Incidence of serious adverse events through Day 540, Incidence of adverse events of special interest through Day 540, Incidence of clinically significant changes in ECGs through Day 540, Incidence of clinically significant changes in ECHOs through Day 540, Change from baseline in the PODCI Global score at Day 540.

Source: https://euclinicaltrials.eu/ctis-public/view/2025-522949-22-00